EU clinical trial 2024-519712-13-00: A PHASE 3 OPEN-LABEL EXTENSION STUDY TO EVALUATE THE LONG-TERM SAFETY AND EFFICACY OF PLOZASIRAN IN ADULTS WITH HYPERTRIGLYCERIDEMIA (SHASTA-10 STUDY)
Protocol code: AROAPOC3-3006
Sponsor: Arrowhead Pharmaceuticals Inc. (Pharmaceutical company). Phase: Therapeutic confirmatory (Phase III). Countries: Lithuania (ongoing, recruiting), Poland (ongoing, recruiting), Latvia (ongoing, recruiting), Slovakia (ongoing, recruiting), Bulgaria (ongoing, recruiting), Spain (ongoing, recruiting), Germany (ongoing, recruiting), Belgium (ongoing, recruiting), Czechia (ongoing, recruiting), Romania (ongoing, recruiting), Croatia (ongoing, recruiting), Hungary (ongoing, recruiting), Italy (ongoing, recruiting), France (ongoing, recruiting).
Therapeutic area(s): Diseases [C] - Nutritional and Metabolic Diseases [C18]
Gender: Female, Male. Age: 18-64 years, 65+ years. Enrolment: 334.
Status: Ongoing, recruiting. Start date (EU): 2025-12-08. Decision date: 2025-06-18. Results received: No. Last updated: 2026-04-27.
Decision dates by country: PL: 2025-06-24, BE: 2025-06-19, HR: 2025-06-24, HU: 2025-06-23, IT: 2025-07-28, LT: 2025-06-18, DE: 2025-08-01, LV: 2025-06-18, SK: 2025-06-18, FR: 2025-06-18, CZ: 2025-07-21, RO: 2025-06-19, ES: 2025-06-19, BG: 2025-06-19

Condition(s): Hypertriglyceridemia (HTG)
Product: ARO-APOC3 PFS

Primary endpoint: Subject incidence of treatment-emergent adverse events (TEAEs)
Endpoint(s): Change and percent change from baseline over time in fasting TG levels, Change and percent change from baseline over time in APOC3, Change and percent change from baseline over time in remnant cholesterol, Change and percent change from baseline over time in fasting non-HDL-C, Change and percent change from baseline over time in fasting HDL-C, Change and percent change from baseline over time in fasting total Apo B, Change and percent change from baseline over time in fasting LDL-C using ultracentrifugation, Change from baseline over time in hemoglobin A1c (HbA1c), Subject incidence of emergent apheresis, Adjudicated MACE event rates during the treatment period, Incidence and titers of ADA to plozasiran in those receiving plozasiran over time, Adjudicated AP event rate during the treatment period.

Source: https://euclinicaltrials.eu/ctis-public/view/2024-519712-13-00